EU clinical trial 2025-521854-40-00: Pharmacokinetic Study of Rezafungin in Patients with Suspected Intra-Abdominal Candidiasis: Peritoneal Diffusion and Candicidal Activity
Protocol code: REZAPACQ
Sponsor: Fundacion Para La Investigacion Biomedica Del Hospital Universitario Ramon Y Cajal (Laboratory/Research/Testing facility). Phase: Therapeutic use (Phase IV). Countries: Spain (ongoing, recruitment ended).
Therapeutic area(s): Diseases [C] - Bacterial Infections and Mycoses [C01]
Gender: Female, Male. Age: 18-64 years. Enrolment: 20.
Status: Ongoing, recruitment ended. Start date (EU): 2025-12-22. Decision date: 2025-08-13. Results received: No. Last updated: 2025-12-16.

Condition(s): Intra-Abdominal Candidiasis.
Product: REZZAYO 200 mg powder for concentrate for solution for infusion

Primary endpoint: Peritoneal diffusion rate of Rezafungin. Ratio of Cmax, Cmin and Area Under the Rezafungin Curve in peritoneal fluid to Cmax, Cmin and Area Under the Rezafungin Curve in blood., Analysis of peritoneal fluid death curves in the samples per patient obtained according to the previous point.
Endpoint(s): Duration of treatment., Overall mortality, Attributable mortality., Clinical and microbiological cure.

Source: https://euclinicaltrials.eu/ctis-public/view/2025-521854-40-00